EU clinical trial 2024-517696-21-01: A multicenter, open-label, dose-escalation clinical trial to evaluate the safety of viral-specific T-cell (VST) therapy in the treatment of refractory viral infections after allogeneic hematopoietic stem cell transplantation or CAR-T therapy (ALLOVISTA).
Protocol code: 2020/ABM/01/00125
Sponsor: Wroclaw Medical University (Educational Institution). Phase: Human Pharmacology (Phase I)- First administration to humans. Countries: Poland (authorised, recruitment pending).
Therapeutic area(s): Diseases [C] - Virus Diseases [C02]
Gender: Female, Male. Age: 18-64 years, 65+ years. Enrolment: 18.
Status: Authorised, recruitment pending. Decision date: 2025-04-22. Results received: No. Last updated: 2026-07-07.

Condition(s): Resistant viral infections caused by cytomegalovirus (CMV) in adult patients after allogeneic hematopoietic stem cell transplantation.

Source: https://euclinicaltrials.eu/ctis-public/view/2024-517696-21-01